EU clinical trial 2023-508619-22-00: A Phase 1/2, Multicenter, Open-Label Study to Determine the Safety, Pharmacokinetics, and Pharmacodynamics of DNL310 in Pediatric Participants with Hunter Syndrome
Protocol code: DNLI-E-0002
Sponsor: Denali Therapeutics Inc. (Pharmaceutical company). Phase: Phase I and Phase II (Integrated)- First administration to humans. Countries: Netherlands (ended).
Therapeutic area(s): Diseases [C] - Congenital, Hereditary, and Neonatal Diseases and Abnormalities [C16]
Gender: Male. Age: 0-17 years, 18-64 years. Enrolment: 2.
Status: Ended. Start date (EU): 2021-06-22. End date (EU): 2026-05-13. Decision date: 2024-06-06. Results received: No. Last updated: 2026-02-26.

Condition(s): Hunter Syndrome (Mucopolysaccharidosis Type II [MPS II])

Primary endpoint: Incidence and severity of treatment-emergent adverse events (TEAEs) throughout the 24-week study period, the safety extension (Week 104), the open-label extension (Week 261), and across the study, Incidence and severity of infusion-related reactions (IRRs) throughout the 24-week study period, the safety extension (Week 104), the open-label extension (Week 261), and across the study, Change from baseline in urine total glycosaminoglycan (GAG) concentration throughout the 24-week study period, the safety extension (Week 104), the open-label extension (Week 261), and across the study, Change from baseline in concomitant medication throughout the 24-week study period, the safety extension (Week 104), the open-label extension (Week 261), and across the study
Endpoint(s): Percent change from baseline in cerebrospinal fluid (CSF) of heparan sulfate [Time Frame:24 weeks], Participants with improvement in individual disease progression in the Vineland Adaptive Behavior Scale Adaptive Behavior Composite (ABC) score [Time Frame: 49 weeks], Participants with improvement in individual disease progression in the Vineland Adaptive Behavior Scale subdomain scores [Time Frame: 49 weeks], PK parameter: Maximum observed concentration (Cmax) of DNL310 in serum [Time Frame: 24 weeks], PK parameter: Trough concentration (Cmin) of DNL310 in serum [Time Frame: 24 weeks], PK parameter: Time to maximum observed concentration (tmax) of DNL310 in serum [Time Frame: 24 weeks], PK parameter: Area under the concentration-time curve from time zero to the time of last quantifiable concentration (AUClast) of DNL310 in serum [Time Frame: 24 weeks], PK parameter: Area under the concentration-time curve from time zero to infinity (AUC∞) of DNL310 in serum [Time Frame: 24 weeks], PK parameter: Area under the concentration-time curve over a dosing interval (AUCτ) of DNL310 in serum [Time Frame: 24 weeks], PK parameter: Apparent terminal elimination half-life (t½) of DNL310 in serum [Time Frame: 24 weeks], Characterization of immunogenicity of DNL310 in serum, as measured by the incidence of anti-drug antibodies (ADAs) relative to baseline [Time Frame: 24 weeks], Percent change from baseline in urine concentration of heparan sulfate (HS) [Time Frame: 24 weeks], Participants with liver volume in the normal range [Time Frame: 24 weeks and 49 weeks], Percentage change form baseline in liver volume [Time Frame: 24 weeks and 49 weeks]

Source: https://euclinicaltrials.eu/ctis-public/view/2023-508619-22-00